EU clinical trial 2023-507803-76-00: A Phase 2/3, Randomized, Open-Label Study Comparing the Efficacy and Safety of the Combination of Beleodaq-CHOP or Folotyn-COP to the CHOP Regimen Alone in Newly Diagnosed Patients with Peripheral T- Cell Lymphoma
Protocol code: SPI-BEL-301
Sponsor: Acrotech Biopharma Inc. (Pharmaceutical company). Phase: Phase II and Phase III (Integrated). Countries: Poland (ongoing, recruiting), Germany (authorised, recruiting), Italy (ongoing, recruiting), Spain (ongoing, recruiting), Hungary (ongoing, recruiting).
Therapeutic area(s): Diseases [C] - Neoplasms [C04]
Gender: Female, Male. Age: 18-64 years, 65+ years. Enrolment: 145.
Start date (EU): 2024-09-26. Decision date: 2024-07-22. Results received: No. Last updated: 2026-08-04.
Decision dates by country: HU: 2024-07-24, PL: 2024-07-29, ES: 2024-07-22, IT: 2024-07-24, DE: 2024-07-24

Condition(s): Peripheral T-Cell Lymphoma
Product: Belinostat, VINCRISTINE SULFATE, DOXORUBICIN, PREDNISONE, Pralatrexate, CYCLOPHOSPHAMIDE

Primary endpoint: The primary endpoint is PFS, defined as the time (months) from randomization to the first documented PD or death, whichever occurs first.
Endpoint(s): • Overall survival is defined as time from randomization to death due to any cause. Overall survival will be censored at the date patients were last known to be alive. • Objective response rate is defined as the percentage of patients who have a CR or PR as their best objective response. • Treatment compliance- Dose delays and reduction of the treatment arms will be evaluated.

Source: https://euclinicaltrials.eu/ctis-public/view/2023-507803-76-00